EU clinical trial 2024-513996-42-00: Risk-benefit analysis of intrathecal morphine administration to patients undergoing surgical treatment of proximal femoral fracture (monocentric, single-blinded, randomized clinical study compared to standard treatment)
Sponsor: Fakultni Nemocnice Ostrava (Hospital/Clinic/Other health care facility). Phase: Therapeutic confirmatory (Phase III). Countries: Czechia (ended).
Therapeutic area(s): Diseases [C] - Musculoskeletal Diseases [C05]
Gender: Female, Male. Age: 18-64 years, 65+ years. Enrolment: 100.
Status: Ended. End date (EU): 2025-09-30. Decision date: 2024-10-31. Results received: No. Last updated: 2024-10-31.

Condition(s): proximal femur fracture
Product: MORPHINE

Primary endpoint: pain assessment using VAS10 at rest (value 0-10 according to pain intensity, measured every 2 h for 24 h), pain assessment using VAS10 while positioning the patient, time until the first administration of rescue medication – analgesics, total consumption of opioids in the ICU per 24 h, the dose of administered non-opioid analgesics
Endpoint(s): monitoring of hypoventilation, monitoring of hypotension, monitoring of bradycardia, postoperative nausea and vomiting, effect of antiemetic mediation, monitoring of pruritus, the effectiveness of the treatment of pruritus

Source: https://euclinicaltrials.eu/ctis-public/view/2024-513996-42-00